EU clinical trial 2025-524342-96-00: Colonic Intramural Injections of Botulin toxin versus placebo to treat fragmented defecation and urgency after restorative total mesorectal excision (TME) for rectal cancer
Sponsor: UZ Leuven (Hospital/Clinic/Other health care facility). Phase: Therapeutic exploratory (Phase II). Countries: Belgium (authorised, recruitment pending).
Therapeutic area(s): Diseases [C] - Digestive System Diseases [C06]; Diseases [C] - Neoplasms [C04]
Gender: Female, Male. Age: 18-64 years, 65+ years. Enrolment: 20.
Status: Authorised, recruitment pending. Decision date: 2026-04-02. Results received: No. Last updated: 2026-04-02.

Condition(s): Rectal Cancer
Product: BOTOX 100 Allergan Units Powder for solution for injection, 0.9% sodium chloride solution for injection (NaCl 0.9%).

Primary endpoint: Difference in LARS score between BoNTA and placebo groups at 3 months.
Endpoint(s): - Secondary endpoints: Clinical assessments at 1, 3, and 6 months; patient-reported outcomes (LARS, Wexner, EORTC QLQ-C30 and QLQ-CR29); episodes of urgency/fragmented defecation; colonic manometry parameters; adverse events.

Source: https://euclinicaltrials.eu/ctis-public/view/2025-524342-96-00